EU clinical trial 2024-515772-12-00: KEYMAKER-U01 Substudy 01G: A Phase 2, Umbrella Study With Rolling Arms of Investigational Agents in Combination With Pembrolizumab With or Without Platinum-based Chemotherapy in Treatment-Naïve Participants With Stage IV Non-small Cell Lung Cancer (NSCLC)
Protocol code: MK-3475-01G
Sponsor: Merck Sharp & Dohme LLC (Pharmaceutical company). Phase: Therapeutic exploratory (Phase II). Countries: Greece (ongoing, recruitment ended), Italy (ongoing, recruitment ended), Spain (ongoing, recruitment ended), Hungary (ongoing, recruitment ended), Poland (ongoing, recruitment ended).
Therapeutic area(s): Diseases [C] - Neoplasms [C04]
Gender: Female, Male. Age: 18-64 years, 65+ years. Enrolment: 61.
Status: Ongoing, recruitment ended. Start date (EU): 2025-04-18. Decision date: 2025-04-08. Results received: No. Last updated: 2026-07-28.
Decision dates by country: PL: 2025-04-14, IT: 2025-04-09, ES: 2025-04-08, HU: 2025-04-11, GR: 2025-04-10

Condition(s): Lung neoplasm malignant (Stage IV Non-small cell lung cancer)
Product: CARBOPLATIN, PACLITAXEL, KEYTRUDA 25 mg/mL concentrate for solution for infusion, MK-1022, PACLITAXEL ALBUMIN-BOUND, PEMETREXED

Primary endpoint: Objective Response Rate (ORR), Number of Participants Who Experience an Adverse Event (AE), Number of Participants Who Discontinue Study Treatment Due to an AE
Endpoint(s): Duration of Response (DOR), Progression-Free Survival (PFS), Overall Survival (OS)

Source: https://euclinicaltrials.eu/ctis-public/view/2024-515772-12-00